EU clinical trial 2024-511448-17-02: Safety Assessment of 10-Day Daily Bucco-Oral Administration of Transfer Factor in Healthy Adult Human Subjects
Protocol code: CPA 556-24
Sponsor: Cepha s.r.o., Aumed a.s. (Pharmaceutical company). Phase: Human Pharmacology (Phase I)- First administration to humans. Countries: Czechia (ended).
Therapeutic area(s): Diseases [C] - Immune System Diseases [C20]
Gender: Female, Male. Age: 18-64 years. Enrolment: 16.
Status: Ended. Start date (EU): 2024-10-16. End date (EU): 2024-11-18. Decision date: 2024-10-15. Results received: No. Last updated: 2024-10-15.

Condition(s): healthy subjects, It is used in conditions with decreased immunity to enhance it e.g. in case of recurrent and chronic viral infections.

Source: https://euclinicaltrials.eu/ctis-public/view/2024-511448-17-02